EU clinical trial 2024-515109-24-00: Measuring Oncological Value of Exercise and Statin (MOVES)
Protocol code: MOVES
Sponsor: Pirkanmaan hyvinvointialue (Hospital/Clinic/Other health care facility). Phase: Therapeutic confirmatory (Phase III). Countries: Finland (ongoing, recruiting).
Therapeutic area(s): Diseases [C] - Neoplasms [C04]; Diseases [C] - Female Urogenital Diseases and Pregnancy Complications [C13]; Diseases [C] - Male Urogenital Diseases [C12]
Gender: Female, Male. Age: 18-64 years, 65+ years. Enrolment: 240.
Status: Ongoing, recruiting. Start date (EU): 2023-03-31. Decision date: 2024-08-20. Results received: No. Last updated: 2026-05-21.

Condition(s): Metastatic breast, ovarian, prostate and kidney cancer
Product: Lipistad 40 mg kalvopäällysteiset tabletit

Primary endpoint: Cancer progression (based on radiological, biochemical or clinical evaluation) and mortality (evaluated by time from starting 1. line cancer treatment to death)

Source: https://euclinicaltrials.eu/ctis-public/view/2024-515109-24-00